EU clinical trial 2025-524267-20-00: An open label, balanced, randomized, two-treatment, two-period, two-sequence, single-dose, crossover bioequivalence study comparing Trametinib tablets 2 mg, Manufactured by Sun Pharmaceutical Industries Limited, India with MEKINIST® (Trametinib) tablets 2 mg, Distributed by: Novartis Pharmaceuticals Corporation, East Hanover, New Jersey 07936, USA in healthy, adult, human subjects under fasting condition.
Protocol code: TRAME-13-25
Sponsor: Sun Pharmaceutical Industries Limited (Pharmaceutical company). Phase: Human Pharmacology (Phase I)- Bioequivalence Study. Countries: Romania (authorised, recruitment pending).
Therapeutic area(s): Diseases [C] - Neoplasms [C04]
Gender: Female, Male. Age: 18-64 years. Enrolment: 72.
Status: Authorised, recruitment pending. Decision date: 2026-04-30. Results received: No. Last updated: 2026-04-30.

Condition(s): Adjuvant treatment of BRAF V600E or V600K mutation-positive melanoma (in combination with dabrafenib);, BRAF V600E mutation-positive unresectable or metastatic solid tumors;, BRAF V600E mutation-positive metastatic non-small cell lung cancer (NSCLC), in combination with dabrafenib;, BRAF V600E mutation-positive low-grade glioma (LGG)., BRAF V600E mutation-positive locally advanced or metastatic anaplastic thyroid cancer (ATC);, BRAF V600E or V600K mutation-positive unresectable or metastatic melanoma, as a single agent in BRAF-inhibitor treatment-naïve patients or in combination with dabrafenib;

Source: https://euclinicaltrials.eu/ctis-public/view/2025-524267-20-00